EU clinical trial 2023-507125-41-00: C4891024 - TACTIVE-U: AN INTERVENTIONAL SAFETY AND EFFICACY PHASE 1B/2, OPEN-LABEL UMBRELLA STUDY TO INVESTIGATE TOLERABILITY, PK, AND ANTITUMOR ACTIVITY OF VEPDEGESTRANT (ARV-471/PF-07850327), AN ORAL PROTEOLYSIS TARGETING CHIMERA, IN COMBINATION WITH OTHER ANTICANCER TREATMENTS IN PARTICIPANTS AGED 18 AND OLDER WITH ER+ ADVANCED OR METASTATIC BREAST CANCER, SUB-STUDY C (ARV-471 IN COMBINATION WITH SAMURACICLIB)
Protocol code: C4891024
Sponsor: Pfizer Inc. (Pharmaceutical company). Phase: Phase I and Phase II (Integrated)- Other. Countries: Italy (ended), Spain (ended), France (ended), Belgium (ended).
Therapeutic area(s): Diseases [C] - Neoplasms [C04]
Gender: Female, Male. Age: 18-64 years, 65+ years. Enrolment: 48.
Status: Ended. Start date (EU): 2024-03-25. End date (EU): 2025-11-26. Decision date: 2024-02-26. Results received: No. Last updated: 2025-11-28.
Decision dates by country: FR: 2024-04-23, BE: 2024-02-28, ES: 2024-04-19, IT: 2024-02-28

Condition(s): Advanced or Metastatic Breast Cancer
Product: CT7001, PF-07850327 round

Primary endpoint: Phase 1b: DLTs during DLT observation period (Cycle 1)., Phase 2: Confirmed OR (CR or PR) determined by investigator assessment., DDI Assessment Cohort(s): Steady-state AUCtau and Cmax of ARV-471 with and without coadministration of samuraciclib, Single dose AUC0-72 and Cmax of samuraciclib with and without coadministration of ARV-471.
Endpoint(s): Phase 1b: • Incidence of AEs and SAEs. • Incidence of laboratory abnormalities. • Incidence of ECG abnormalities, Phase 1b: • Confirmed OR (CR or PR) by investigator assessment. • DoR by investigator assessment. • CBR (confirmed CR or PR at any time, or SD ≥24 weeks) by investigator assessment. • PFS by investigator assessment., Phase 1b: Plasma concentrations of ARV-471, ARV-473, and samuraciclib., Phase 2: • DoR by investigator assessment. • CBR (confirmed CR or PR at any time or SD ≥24 weeks) by investigator assessment. • PFS by investigator assessment. • OS., Phase 2: • Incidence of AEs and SAEs. • Incidence of laboratory abnormalities. • Incidence of ECG abnormalities., Phase 2: Plasma concentrations of ARV-471, ARV-473 and samuraciclib., Phase 2: ctDNA plasma quantitative changes from pre-treatment to evaluate potential predictability of their associations with clinical outcomes., Phase 2: TP53 status defined from analysis of baseline ctDNA., DDI Assessment Cohort(s): Incidence of AEs and SAEs, Incidence of laboratory abnormalities, Incidence of ECG abnormalities.

Source: https://euclinicaltrials.eu/ctis-public/view/2023-507125-41-00